EU clinical trial 2022-501947-34-00: A Phase 2 Dose Finding Study Evaluating the Safety and Efficacy of Linaclotide in Pediatric Subjects 6 Months to Less Than 2 Years of Age with Functional Constipation (FC).
Protocol code: M21-862
Sponsor: Abbvie Deutschland GmbH & Co. KG (Pharmaceutical company). Phase: Therapeutic exploratory (Phase II). Countries: Bulgaria (ended), Hungary (ended), Croatia (ended), Germany (ended).
Therapeutic area(s): Diseases [C] - Nutritional and Metabolic Diseases [C18]
Gender: Female, Male. Age: 0-17 years. Enrolment: 14.
Status: Ended. Start date (EU): 2023-12-05. End date (EU): 2025-05-01. End date: 2025-06-09. Decision date: 2023-10-09. Results received: Yes. Last updated: 2025-04-07.
Decision dates by country: HR: 2023-10-10, HU: 2023-10-11, BG: 2023-10-11, DE: 2023-10-09

Condition(s): Functional Constipation (FC)
Product: Linaclotide, Linaclotide Placebo, Linaclotide, Linaclotide

Primary endpoint: Change from baseline in 4-week overall SBM frequency rate (SBMs/week) during the Study Intervention Period, Change from baseline in 4-week stool consistency (Bristol Stool Form Scale) reported by legally authorized representative (LAR)/parent/guardian/caregiver during the Study Intervention Period, Change from baseline in 4-week straining reported by LAR/parent/guardian/caregiver during the Study Intervention Period

Source: https://euclinicaltrials.eu/ctis-public/view/2022-501947-34-00